EU clinical trial 2023-510559-41-00: A phase II study of Taxane-Platinum based chemotherapy with cetuximab followed by a maintenance with avelumab and cetuximab in First Line Recurrent or Metastatic Squamous Cell Carcinoma of the Head and Neck (R/M SCCHN).
Protocol code: GORTEC 2024-01
Sponsor: Groupe Oncologie Radiotherapie Tete Cou (Patient organisation/association). Phase: Therapeutic exploratory (Phase II). Countries: France (ongoing, recruiting).
Therapeutic area(s): Diseases [C] - Neoplasms [C04]
Gender: Female, Male. Age: 18-64 years, 65+ years. Enrolment: 73.
Status: Ongoing, recruiting. Start date (EU): 2026-06-15. Decision date: 2024-11-12. Results received: No. Last updated: 2026-06-12.
Decision dates by country: FR: 2024-12-04

Condition(s): Recurrent or Metastatic Squamous Cell Carcinoma of the Head and Neck
Product: Erbitux 5 mg/mL solution for infusion, Bavencio 20 mg/mL concentrate for solution for infusion, Erbitux 5 mg/mL solution for infusion, Cisplatin 1 mg/ml concentrate for solution for Infusion, Carboplatin Accord Healthcare 10 mg/ml, solution à diluer pour de perfusion, Paclitaxel Accord Healthcare 6 mg/ml solution à diluer pour perfusion

Primary endpoint: Overall survival (OS) defined as the time between inclusion and death from any cause or the last follow-up contact for patients who are alive.
Endpoint(s): Progression free survival (PFS) defined as the time between inclusion and first progression according to RECIST 1.1., Incidence and severity of adverse events and serious adverse events during maintenance by the combination of cetuximab and avelumab and until 3 months after the last administration of maintenance (or until the start of a second line treatment if it starts before 3 months) as graded by the NCI Common Terminology Criteria of Adverse Events (NCI-CTCAE) v 5.0.

Source: https://euclinicaltrials.eu/ctis-public/view/2023-510559-41-00